EU clinical trial 2023-509029-29-00: ISIS 678354-CS13: An Open-Label Extension Study of AKCEA-APOCIII-LRX Administered Subcutaneously to Patients with Familial Chylomicronemia Syndrome (FCS)
Protocol code: ISIS 678354-CS13
Sponsor: Ionis Pharmaceuticals Inc. (Pharmaceutical company). Phase: Therapeutic confirmatory (Phase III). Countries: Sweden (ongoing, recruitment ended), Spain (ongoing, recruitment ended), Slovakia (ongoing, recruitment ended), Netherlands (ended), Portugal (ongoing, recruitment ended), Italy (ongoing, recruitment ended), France (ongoing, recruitment ended).
Therapeutic area(s): Diseases [C] - Congenital, Hereditary, and Neonatal Diseases and Abnormalities [C16]
Gender: Female, Male. Age: 18-64 years, 65+ years. Enrolment: 30.
Start date (EU): 2022-06-29. Decision date: 2024-08-12. Results received: No. Last updated: 2026-05-22.
Decision dates by country: NL: 2024-08-13, IT: 2024-09-02, PT: 2024-08-16, FR: 2024-09-26, SE: 2024-08-12, ES: 2024-08-12, SK: 2024-08-14

Condition(s): Familial Chylomicronemia Syndrome (FCS)
Product: ISIS 678354, ISIS 678354, ISIS 678354

Primary endpoint: The primary objective is to evaluate safety and tolerability of treatment with olezarsen
Endpoint(s): Percent change in fasting TG from Baseline at Month 6 (average of Weeks 23, 25 and 27), Percent change in fasting TG from Baseline at Month 12 (average of Week 51 and 53), Month 24 (average of Week 103 and Week 105) and Month 36 (average of Week 155 and Week 157), and Month 48 (average of Week 205 and 209), Proportion of patients who achieve ≥ 40% reduction in fasting TG from Baseline at Month 6, 12, 24, 36, 48, Percent change in fasting apoB48 from Baseline at Month 6, 12, 24, 36, 48, Percent change in fasting apoC-III from Baseline at Month 6, 12, 24, 36, 48, Percent change in fasting non-HDL from Baseline at Month 6, 12, 24, 36, 48, Proportion of patients who achieve fasting TG 880mg/dL at Month 6, 12, 24, 36, 48, Adjudicated acute pancreatitis event rate during the Treatment Period (Week 1 through Week 53, 105, 157 or 209), Adjudicated acute pancreatitis event rate during the Treatment Period (Week 1 through Week 53, 105 157 or 209), in patients with ≥ 2 events of adjudicated acute pancreatitis in 5 years prior to treatment with study drug in the index study, Adjudicated acute pancreatitis event rate during the Treatment Period (Week 1 through Week 53, 105 157 or 209) in patient with a prior history of pancreatitis within 10 years prior to Screening in the index study, Proportion of patients who achieve ≥ 70% reduction in fasting TG from Baseline at Month 6, 12, 24, 36, 48, Proportion of patients who achieve fasting TG ≤ 500 mg/dL at Month 6, 12, 24, 36, 48

Source: https://euclinicaltrials.eu/ctis-public/view/2023-509029-29-00